EU clinical trial 2022-501452-29-00: Investigation-specific Appendix 2to Master Protocol PLATFORMPANSC2001 (KALEIDOSCOPE) A Phase 1/2 Study Evaluating the Safety and Efficacy of Amivantamab and Cetrelimab Combination Therapy in Metastatic Non-small Cell Lung Cancer - PolyDamas
Protocol code: 61186372PANSC2002
Sponsor: Janssen - Cilag International (Pharmaceutical company). Phase: Phase I and Phase II (Integrated)- Other. Countries: Poland (ended), Italy (ended), Spain (ongoing, recruitment ended).
Therapeutic area(s): Diseases [C] - Neoplasms [C04]
Gender: Female, Male. Age: 18-64 years, 65+ years. Enrolment: 26.
Start date (EU): 2024-08-28. Decision date: 2024-07-22. Results received: No. Last updated: 2026-04-20.
Decision dates by country: PL: 2024-07-29, IT: 2024-07-22, ES: 2024-07-24

Condition(s): Metastatic Non-small Cell Lung Cancer
Product: JNJ-61186372, JNJ-63723283, JNJ-63723283

Primary endpoint: 1. Incidence and severity of AEs, including dose limiting toxicities (DLTs), 2. Objective response rate (ORR) according to RECIST v1.1 by investigator review; confirmatory analysis may be performed using blinded independent central review (BICR)

Source: https://euclinicaltrials.eu/ctis-public/view/2022-501452-29-00